EU clinical trial 2024-515368-29-00: "A Phase III, Randomized Clinical Trial of Standard Adjuvant Endocrine Therapy +/- Chemotherapy in Patients with 1-3 Positive Nodes, Hormone Receptor-Positive and HER2-Negative Breast Cancer with Recurrence Score (RS) of 25 or Less. RxPONDER: A Clinical Trial Rx for Positive Node, Endocrine Responsive Breast Cancer.” RXPONDER
Protocol code: GEICAM/2011-03_S1007
Sponsor: Fundacion Grupo Espanol De Investigacion En Cancer De Mama (Patient organisation/association). Phase: Therapeutic confirmatory (Phase III). Countries: Spain (ongoing, recruitment ended).
Therapeutic area(s): Diseases [C] - Neoplasms [C04]
Gender: Female. Age: 18-64 years, 65+ years. Enrolment: 792.
Status: Ongoing, recruitment ended. Start date (EU): 2012-09-20. Decision date: 2024-10-10. Results received: No. Last updated: 2026-07-08.

Condition(s): patients with node positive breast cancer who do not have high Recurrence Scores (RS) by Oncotype DX®
Product: DOXORUBICIN, EPIRUBICIN, CYCLOPHOSPHAMIDE, TAMOXIFEN, EXEMESTANE, LETROZOLE, DOCETAXEL, FLUOROURACIL, ANASTROZOLE, PACLITAXEL

Primary endpoint: Invasive Recurrence
Endpoint(s): Invasive Disease-Free Survival, Distant Disease-Free Survival, Local Disease-Free Interval., Overall Survival

Source: https://euclinicaltrials.eu/ctis-public/view/2024-515368-29-00